EU clinical trial 2024-516106-31-00: STAR-TREC: Can we Save the rectum by watchful waiting or TransAnal surgery following (chemo)Radiotherapy versus Total mesorectal excision for early REctal Cancer?
Protocol code: RG_15-011
Sponsor: The University Of Birmingham (Educational Institution). Phase: Phase II and Phase III (Integrated). Countries: Netherlands (ongoing, recruitment ended), Belgium (ongoing, recruitment ended), Sweden (ongoing, recruitment ended).
Therapeutic area(s): Diseases [C] - Digestive System Diseases [C06]
Gender: Female, Male. Age: 18-64 years, 65+ years. Enrolment: 230.
Status: Ongoing, recruitment ended. Start date (EU): 2017-06-16. Decision date: 2024-11-13. Results received: No. Last updated: 2024-11-15.
Decision dates by country: SE: 2024-11-15, NL: 2024-11-13, BE: 2024-11-14

Condition(s): Early stage colorectal cancer
Product: Capecitabine Glenmark 150 mg film-coated tablets

Primary endpoint: Phase II: The primary endpoint of the STAR-TREC feasibility study is - Recruitment rate measured at 12 and 24 months., Phase III: The primary endpoint of the STAR-TREC phase III study is the proportion of patients with successful organ preservation at 30 months from the start day of (chemo)radiotherapy treatment.
Endpoint(s): A) Secondary outcomes for the randomised comparison between organ-preserving strategies:, * Clinician-reported acute treatment-related toxicity up to 30 days following completion of (chemo)radiotherapy, * Proportion of patients with complete response to (chemo)radiation therapy, * Proportion of patients undergoing transanal local excision, * Time to event of organ loss assessed for patients who prefer organ preservation; defined as the length of time from the start date of trial treatment until TME surgery, * Non-regrowth pelvic tumour control to 36 months; defined as the length of time from the start date of trial treatment until death (any cause) or development of unequivocal pelvic recurrence but not including patients who developed local regrowth which was resected with clear margins using standard TME surgery, * Metastasis-free survival to 36 months; defined as the length of time from the start date of trial treatment until death (any cause) or detection of distant metastasis, * Non-regrowth -disease free survival to 36 months; defined as the length of time from the start of trial treatment until death (any cause), detection of local pelvic recurrence or distant metastasis but not including patients who developed local regrowth which was resected with clear margins using standard TME surgery, * Overall survival to 60 months; defined as the length of time from the start date of trial treatment until death (any cause), B) Secondary endpoints for analyses incorporating the standard surgery comparator (phase II: randomised comparison; phase III: non-randomised comparison):, * Clinician-reported acute treatment related toxicity up to 30 days following completion of (chemo)radiotherapy or date of initial surgery, * Non-regrowth pelvic tumour control to 36 months; defined as the length of time from the start date of trial treatment or date of initial surgery until death (any cause) or development of unequivocal pelvic recurrence but not including patients who preferred organ preservation and developed local regrowth which was resected with clear margins using standard TME surgery, * Metastasis-free survival to 36 months; defined as the length of time from the start date of trial treatment or date of initial surgery until death (any cause) or detection of distant metastasis, * Disease-free survival to 36 months; defined as the length of time from the start date of trial treatment or date of initial surgery until death (any cause), detection of local pelvic recurrence or distant metastasis but not including patients who developed local regrowth which was resected with clear margins using standard TME surgery, * Overall survival to 60 months; defined as the length of time from the start date of trial treatment or date of initial surgery until death (any cause), * Decision regret at 24 months measured using the validated Decision regret scale questionnaire, C) Secondary endpoints for analyses of patient-reported outcomes, * Symptomatic toxicity, health economics and HRQoL measured at 3, 12, 24 and 36 months compared to baseline using validated questionnaires (HRQoL booklet) This analysis will be conducted incorporating the following comparisons:, a. Randomised comparison between organ-preserving strategies, b. Randomised (phase II data) and non-randomised (phase III data) comparisons between organ preserving strategies and the standard surgery comparator

Source: https://euclinicaltrials.eu/ctis-public/view/2024-516106-31-00